EU clinical trial 2023-510054-16-00: NECESSITY – « New Clinical End-points in patients with primary Sjögren’s Syndrome: an Interventional Trial based on stratifYing patients »
Protocol code: APHP190131
Sponsor: Assistance Publique Hopitaux De Paris (Hospital/Clinic/Other health care facility). Phase: Therapeutic exploratory (Phase II). Countries: Netherlands (ended), Sweden (ended), Greece (ongoing, recruitment ended), Spain (ended), France (ended), Italy (ended), Norway (ongoing, recruitment ended).
Therapeutic area(s): Diseases [C] - Immune System Diseases [C20]; Diseases [C] - Musculoskeletal Diseases [C05]
Gender: Female, Male. Age: 18-64 years, 65+ years. Enrolment: 235.
Start date (EU): 2022-04-26. Decision date: 2024-02-20. Results received: No. Last updated: 2025-04-22.
Decision dates by country: NL: 2024-02-20, SE: 2024-02-20, IT: 2024-03-29, FR: 2024-03-21, ES: 2024-02-26, NO: 2024-02-21, GR: 2024-05-08

Condition(s): Primary Sjogren's syndrome
Product: Placebo of leflunomide, Arava 20 mg film-coated tablets, Mycophenolate mofetil Teva 500 mg film-coated tablets, Placebo of mycophenolate mofetil, Placebo of hydroxychloroquine, PLAQUENIL 200 mg, comprimé pelliculé

Primary endpoint: Proportion of patients achieving a response according to preliminary STAR at week 24 between each active treatment arm and placebo arm. • Cohort 2: Proportion of patients achieving a response according to preliminary STAR at week 24 between each active treatment arm and placebo arm.

Source: https://euclinicaltrials.eu/ctis-public/view/2023-510054-16-00